EU clinical trial 2024-513316-10-00: A Phase 1b Study of AMG 757 in Subjects with Neuroendocrine Prostate Cancer
Protocol code: 20200040
Sponsor: Amgen Inc. (Pharmaceutical company). Phase: Human Pharmacology (Phase I)- Other. Countries: Netherlands (ended), Belgium (ended), France (ended).
Therapeutic area(s): Diseases [C] - Neoplasms [C04]
Gender: Male. Age: 18-64 years, 65+ years. Enrolment: 11.
Status: Ended. Start date (EU): 2021-04-20. End date (EU): 2024-06-07. End date: 2024-07-23. Decision date: 2024-08-02. Results received: No. Last updated: 2024-08-06.
Decision dates by country: BE: 2024-08-02, FR: 2024-08-06, NL: 2024-08-02

Condition(s): Adult subjects with de novo or treatment-emergent neuroendocrine prostate cancer

Source: https://euclinicaltrials.eu/ctis-public/view/2024-513316-10-00